EU clinical trial 2025-522039-33-00: A First-in-Human, Double-Blind, Placebo-Controlled, Multiple Ascending Dose Study of Intrathecally Administered LTX-002 in Adult Participants with Amyotrophic Lateral Sclerosis
Protocol code: LTX-002-101
Sponsor: Leal Therapeutics Inc. (Pharmaceutical company). Phase: Phase I and Phase II (Integrated)- First administration to humans. Countries: Sweden (ongoing, recruiting), Italy (authorised, recruitment pending), Germany (authorised, recruitment pending), Netherlands (ongoing, recruiting).
Therapeutic area(s): Diseases [C] - Nervous System Diseases [C10]
Gender: Female, Male. Age: 18-64 years, 65+ years. Enrolment: 30.
Start date (EU): 2026-04-09. Decision date: 2026-01-23. Results received: No. Last updated: 2026-08-05.
Decision dates by country: DE: 2026-01-23, SE: 2026-02-05, NL: 2026-03-10, IT: 2026-02-19

Condition(s): Amyotrophic Lateral Sclerosis
Product: Placebo is identical to IMP but with no active substance. The placebo consists of a corresponding volume of sterile aCSF solution formulation intended for IT administration., LTX-002

Primary endpoint: Incidence and severity of AEs, TEAEs and SAEs, Clinical laboratory tests (serum chemistry and hematology; urinalysis), ECGs, Vital signs (blood pressure, heart rate, respiratory rate, body temperature), Physical and neurological exams.
Endpoint(s): CSF levels of LTX-002, Single-dose plasma PK parameters for the first and last of the three doses, including Cmax, Tmax, AUC0-t, AUC0-∞, Tlag if applicable, Vd/F, λz, T1/2, and CL/F, Where data are available, AUC0-∞ AUC0 t, and Cmax will be tested for dose proportionality using a power model approach.

Source: https://euclinicaltrials.eu/ctis-public/view/2025-522039-33-00